EU clinical trial 2024-514020-16-00: The effect of perioperative intravenous s-ketamine on acute and chronic postoperative craniotomy pain compared to placebo: a prospective randomized double blind placebo controlled trial (ESPAIN-trial)
Sponsor: Academisch Ziekenhuis Maastricht (Hospital/Clinic/Other health care facility). Phase: Therapeutic use (Phase IV). Countries: Netherlands (ongoing, recruiting).
Therapeutic area(s): Diseases [C] - Nervous System Diseases [C10]
Gender: Female, Male. Age: 18-64 years, 65+ years. Enrolment: 62.
Status: Ongoing, recruiting. Start date (EU): 2018-03-14. Decision date: 2024-12-13. Results received: No. Last updated: 2024-12-13.

Condition(s): Post-craniotomy headache
Product: ESKETAMINE, SODIUM CHLORIDE

Primary endpoint: The primary endpoint is the total postoperative opioid consumption at the 7th postoperative day with interim measurements at 24, 48, 72 and 96 hours postoperatively.
Endpoint(s): Secondary endpoints will be the length of hospital stay, patient health-related quality of life (RAND SF-36 questionnaire), psychological parameters (questionnaires below cited), adverse events, and postoperative pain scores (VAS+NRS) during the first 7 postoperative days.

Source: https://euclinicaltrials.eu/ctis-public/view/2024-514020-16-00